EU clinical trial 2023-506345-34-00: An open-label, healthy subject, two-part study to assess the effect of verapamil on systemic exposure of EP395 (Part A), and to assess the effect of EP395 on systemic exposure of midazolam and digoxin (Part B)
Protocol code: EP395-004
Sponsor: Epiendo Pharmaceuticals ehf. (Pharmaceutical company). Phase: Human Pharmacology (Phase I)- Other. Countries: Sweden (ended).
Therapeutic area(s): Diseases [C] - Respiratory Tract Diseases [C08]
Gender: Female, Male. Age: 18-64 years. Enrolment: 36.
Status: Ended. Start date (EU): 2023-10-23. End date (EU): 2024-01-02. Decision date: 2023-09-26. Results received: No. Last updated: 2023-09-26.

Condition(s): Chronic obstructive pulmonary disease (COPD)

Source: https://euclinicaltrials.eu/ctis-public/view/2023-506345-34-00